EU clinical trial 2025-523864-19-00: Phase 2 study of iadademstat for the treatment of patients with essential thrombocythemia resistant/intolerant to hydroxyurea
Protocol code: CL06-ORY-1001
Sponsor: Oryzon Genomics S.A. (Pharmaceutical company). Phase: Therapeutic exploratory (Phase II). Countries: Spain (ongoing, recruiting).
Therapeutic area(s): Diseases [C] - Hemic and Lymphatic Diseases [C15]
Gender: Female, Male. Age: 18-64 years, 65+ years. Enrolment: 36.
Status: Ongoing, recruiting. Start date (EU): 2026-04-23. Decision date: 2026-02-20. Results received: No. Last updated: 2026-04-13.

Condition(s): Essential Thrombocythemia

Primary endpoint: Percentage of patients achieving a reduction of platelet counts to ≤400x109/L in the absence of any subsequent thrombotic events while maintaining normal platelet counts, at any time during 24 weeks of treatment, Occurrence, severity of Treatment Emergent Adverse Events (TEAEs) (graded using the Common Terminology Criteria for AEs -CTCAE) v 5.0 criteria

Source: https://euclinicaltrials.eu/ctis-public/view/2025-523864-19-00